EU clinical trial 2025-524160-38-00: A Multicenter, Open-label, Phase 3 Extension Study to Evaluate the Long‑term Efficacy and Safety in Participants Who Are Currently on Treatment in a Belzutifan Study (LITESPARK-043)
Protocol code: MK-6482-043
Sponsor: Merck Sharp & Dohme LLC (Pharmaceutical company). Phase: Therapeutic confirmatory (Phase III). Countries: Czechia (ongoing, recruiting), Spain (ongoing, recruiting), Poland (ongoing, recruiting), Belgium (ongoing, recruiting), Finland (ongoing, recruiting), Germany (authorised, recruitment pending), France (ongoing, recruiting), Netherlands (ongoing, recruiting), Hungary (ongoing, recruiting), Denmark (ongoing, recruiting).
Therapeutic area(s): Diseases [C] - Neoplasms [C04]
Gender: Female, Male. Age: 18-64 years, 65+ years. Enrolment: 37.
Start date (EU): 2026-05-12. Decision date: 2026-04-28. Results received: No. Last updated: 2026-05-05.
Decision dates by country: BE: 2026-04-28, CZ: 2026-04-29, DK: 2026-04-28, FR: 2026-05-04, DE: 2026-04-30, HU: 2026-05-04, ES: 2026-04-28, NL: 2026-04-29, PL: 2026-04-30, FI: 2026-05-05

Condition(s): Renal Cell Carcinoma, hepatocellular carcinoma, nonMSI-H/dMMR colorectal cancer, pancreatic ductal adenocarcinoma, biliary tract cancer, non-MSIH/dMMR endometrial cancer, esophageal squamous cell carcinoma, Advanced Pheochromocytoma/Paraganglioma, Pancreatic Neuroendocrine Tumor, von Hippel-Lindau (VHL)Disease-Associated Tumors, Advanced Gastrointestinal Stromal Tumor, Advanced Solid Tumors With HIF-2α related Genetic Alterations
Product: Lenvatinib, Belzutifan, Lenvatinib

Primary endpoint: Overall survival (OS)
Endpoint(s): Number of Participants Who Experience One or More Adverse Events (AEs), Number of Participants Who Discontinue Study Treatment Due to AEs

Source: https://euclinicaltrials.eu/ctis-public/view/2025-524160-38-00